EU clinical trial 2023-509413-37-00: A Multi-Center, Open-Label Trial to Evaluate the Pharmacokinetics, Safety, and Pharmacodynamics of Subcutaneously Administered Belimumab, a Human Monoclonal Anti-BLyS Antibody, Plus Standard Therapy in Pediatric Participants with Systemic Lupus Erythematosus (SLE)
Protocol code: 200908
Sponsor: Glaxosmithkline Research & Development Limited (Pharmaceutical company). Phase: Therapeutic exploratory (Phase II). Countries: Spain (ended), Germany (ended).
Therapeutic area(s): Phenomena and Processes [G] - Immune system processes [G12]
Gender: Female, Male. Age: 0-17 years. Enrolment: 9.
Status: Ended. Start date (EU): 2020-01-17. End date (EU): 2025-10-23. Decision date: 2024-03-15. Results received: No. Last updated: 2025-07-17.
Decision dates by country: ES: 2024-03-20, DE: 2024-03-15

Condition(s): Systemic Lupus Erythematosus
Product: Benlysta 200 mg solution for injection in pre-filled pen., Benlysta 200 mg solution for injection in pre-filled pen., Benlysta 200 mg solution for injection in pre-filled pen.

Primary endpoint: Observed belimumab concentrations at Week 12., Steady-state PK parameters: Cavg (AUC), Cmax, Cmin (based on population PK estimates).
Endpoint(s): Incidence of adverse events, serious adverse events and adverse events of special interest through Week 52., "Change from baseline in biomarkers (C3/C4, anti-dsDNA, B cell subsets, and immunoglobulins) at Weeks 12 and 52."

Source: https://euclinicaltrials.eu/ctis-public/view/2023-509413-37-00